EU clinical trial 2023-508997-27-00: Comparison of local anaesthesia and regional anaesthesia (PECS II block) on QoR-15 in patients undergoing subpectoral implantation of cardiac implantable electronic devices (CIEDs) - a Prospective, randomized, double-blinded, controlled pragmatic trial with two arms
Protocol code: PECS-CIED
Sponsor: Medizinische Universitaet Innsbruck (Educational Institution). Phase: Therapeutic use (Phase IV). Countries: Austria (ongoing, recruiting).
Therapeutic area(s): Analytical, Diagnostic and Therapeutic Techniques and Equipment [E] - Anesthesia and Analgesia [E03]
Gender: Female, Male. Age: 18-64 years, 65+ years. Enrolment: 80.
Status: Ongoing, recruiting. Start date (EU): 2024-10-14. Decision date: 2024-09-20. Results received: No. Last updated: 2025-12-15.

Condition(s): Need for a subpectoral implantation of cardiac implantable electronic devices (CIEDs)
Product: Xylanaest purum 1 % - Durchstechflaschen, Ropivacainhydrochlorid Sintetica 2 mg/ml Infusionslösung

Primary endpoint: The difference in the Quality of Recovery 15 Score (QoR-15) assessed 24 hours after a subpectoral CIED
Endpoint(s): intraoperative additional local anaesthetic administration, postoperative analgesic consumption, the need and dose of additional analgesia, VAS after 2, 4, 6, 12, and 24 hours, VAS-AUC and VAS groups < 30 mm / 30 - 60 mm / > 60 m, Data regarding hemodynamic stability, the duration of anaesthesia and intervention, any ICU stay, perioperative course of biomarkers (creatinine and troponin), and hospital length of stay, Changes in NYHA stage, LV-EF, and BMI, QoR-15 at 2 hours after CIED-implantation, Linear evolution of QoR-15

Source: https://euclinicaltrials.eu/ctis-public/view/2023-508997-27-00